EU clinical trial 2024-510732-52-00: A SINGLE-CENTER, OPEN-LABEL, TWO-PERIOD STUDY TO INVESTIGATE THE EFFECT OF MULTIPLE DOSE ITRACONAZOLE, A STRONG CYP3A INHIBITOR, ON THE PHARMACOKINETICS OF A SINGLE 30 MG DOSE OF RO7269162 IN HEALTHY PARTICIPANTS
Protocol code: BP45228
Sponsor: F. Hoffmann-La Roche AG (Pharmaceutical company). Phase: Human Pharmacology (Phase I)- Other. Countries: Netherlands (ended).
Therapeutic area(s): Not possible to specify
Gender: Female, Male. Age: 18-64 years. Enrolment: 18.
Status: Ended. Start date (EU): 2024-05-07. End date (EU): 2024-08-01. End date: 2024-08-02. Decision date: 2024-05-01. Results received: No. Last updated: 2024-05-01.

Condition(s): Not applicable, healthy volunteers

Source: https://euclinicaltrials.eu/ctis-public/view/2024-510732-52-00